EU clinical trial 2023-504254-35-00: A multicenter, open-label, non-randomized Phase 1/2 study to assess safety, tolerability, and imaging characteristics of [68Ga]Ga-DPI-4452 and to assess safety, tolerability, and efficacy of [177Lu]Lu-DPI-4452 in patients with unresectable locally advanced or metastatic solid tumors
Protocol code: ITM-9.4.1.1.01CT
Sponsor: ITM Oncologics GmbH (Pharmaceutical company). Phase: Phase I and Phase II (Integrated)- First administration to humans. Countries: France (ongoing, recruiting), Belgium (authorised, recruitment pending).
Therapeutic area(s): Diseases [C] - Neoplasms [C04]
Gender: Female, Male. Age: 18-64 years, 65+ years. Enrolment: 97.
Start date (EU): 2023-06-20. Decision date: 2024-03-25. Results received: No. Last updated: 2026-07-17.
Decision dates by country: FR: 2024-03-25, BE: 2024-10-09

Condition(s): Unresectable locally advanced or metastatic solid tumors: • Clear cell renal cell carcinoma (ccRCC); • Pancreatic ductal adenocarcinoma (PDAC); • Colorectal Cancer (CRC) (Part A); • Urothelial carcinoma (UC) [Part B/C/E]; • Indeterminate Renal Mass (IDRM) [part D]; • Head and Neck cancer (H&N) [part E]; • Triple Negative breast cancer (TNBC) [part E]; • Squamous non-mall cell lung cancer (NSCLC) [part E]
Product: [177Lu]Lu-DPI-4452, [68Ga]Ga-DPI-4452, DIAMOX 250 mg tabletten

Primary endpoint: 1_Part A: Incidence and severity of treatment-emergent adverse events (TEAEs), serious TEAE and laboratory abnormalities graded according to National Cancer Institute Common Terminology Criteria for Adverse Events (NCICTCAE) v5.0 criteria, 2_Part A: Change in vital signs and electrocardiogram (ECG), 3_Part B: Incidence of dose-limiting toxicities (DLTs), cumulative safety, and available data including but not limited to PK data, dosimetry, changes in laboratory values, vital signs, and ECG, 4_Part C: Objective Response Rate (ORR) defined as the percentage of patients who achieve a partial response or complete response as measured by RECIST v1.1, 5_Part D: Diagnostic concordance between [68Ga]Ga-DPI-4452 uptake by PET imaging in the renal mass and assessment of the histological characteristics of the IDRM, 6_Part E: Radiotracer uptake at lesion level, identified via PET/CT imaging, 7_Part E: TBR SUVmax/SUVmean of lesion versus reference region
Endpoint(s): 1_Part A: PK parameters of radioactivity in blood and urine, 2_Part A: Radioactivity uptake in normal organs and tumor lesions, 3_Part A: Time-Activity Curves from PET/CT images in normal organs and tumor lesions, 4_Part A: Whole-body radiation effective dose, 5_Part A: Residence time and absorbed and effective doses per organ and tumor lesion, 6_Part A: Radioligand [68Ga]Ga-DPI-4452 PET scan time window for optimal imaging, 7_Part A: Radiotracer uptake at lesion level, identified via PET/CT imaging, 8_Part A: TBR SUVmax/ SUVmean of lesion versus reference region, 9_Part A: Number and location of tumor lesions positive detected by [68Ga]Ga- DPI-4452 PET in comparison with the lesions identified by conventional imaging at baseline, 10_Part B: Incidence and severity of TEAEs, serious TEAEs, and laboratory abnormalities, 11_Part B: Incidence of treatment discontinuations and treatment modifications due to TEAEs and laboratory abnormalities, 12_Part B: PK parameters of radioactivity in blood and plasma and in urine, 13_Part B: Radioactivity absorption in normal organs and tumor lesions, 14_Part B: Residence time and radiation doses absorbed in organs and tumor lesions; identification of dose limiting organ(s), 15_Part B: ORR as measured by RECIST v1.1, 16_Part B: OS for patients at the RP2D, 17_Part B: Semi-quantitative assessment of radiotracer absorption at lesion level, identified via whole body planar images and/or S SPECT/CT imaging in Cycle 1, 18_Part B: Comparison of tumor absorption versus absorption by reference region, 19_Part B: 68Ga SUV (max, mean) versus 177Lu absorption in tumoral lesions overall, the lesion with the highest uptake, 20_Part B: Concordance between [68Ga]Ga-DPI-4452 uptake by PET imaging (SUVmax, SUVmean) of the hottest lesion(s) and CA IX expression by IHC measured as H score in the available tumor biopsyy/cytological samples, and % of lesions with uptake concordant with the hottest lesion, 21_Part B: Radioactivity uptake in normal organs and tumor lesions estimated as radiation absorbed dose (Gy/GBq) and as SUV (max, mean), 22_Part B: Time-Activity Curves from from whole body planar images and/or SPECT/CT images in normal organs and tumor lesions, 23_Part B: Residence time and radiation doses absorbed in organs and tumor lesions, 24_Part B: Number and location of tumor lesions positive detected by [68Ga]Ga- DPI-4452 PET in comparison with the standard imaging, 25_Part B: Incidence and severity of TEAEs, serious TEAEs, and laboratory abnormalities, 26_Part C: Incidence and severity of TEAEs, serious TEAEs, and laboratory abnormalities, 27_Part C: Incidence of treatment discontinuations and treatment modifications due to TEAEs and laboratory abnormalities, 28_Part C: OS, 29_Part C: Number and location of PET positive tumor lesions compared with the lesions identified at standard imaging (by RECIST v1.1), 30_Part C: In a subset of patients: PK parameters of radioactivity in blood, plasma and in urine, 31_Part C: In a subset of patients: Radioactivity absorption in normal organs and tumor lesions, 32_Part C: In a subset of patients: Time-Activity Curves from whole body planar images and/or SPECT/CT images in normal organs and tumor lesions, 33_Part C: In a subset of patients: Residence time and radiation doses absorbed in organs and tumor lesions; identification of dose limiting organ(s), 34_In a subset of patients: Semi-quantitative assessment of radiotracer uptake at lesion level, identified via whole body planar images and/or SPECT/CT imaging, 35_In a subset of patients: Comparison of tumor absorption versus absorption by reference region, 36_In a subset of patients: 68Ga SUV (max, mean) versus 177Lu absorption in tumoral lesions, 37_Part C Concordance between [68Ga]Ga-DPI-4452 uptake by PET imaging (SUVmax, SUVmean) of the hottest lesion(s) and CA IX expression by IHC measured as H score in the available tumor biopsyy/cytological samples, and % of lesions with uptake concordant with the hottest lesion, 38_Incidence and severity of TEAEs, serious TEAEs, and laboratory abnormalities, 39_Parts B, C: Change in vital signs and ECG, 40_Parts B, C: PFS rate at 6 months, PFS, DoR and DCR, 41_Part D: Sensitivity, specificity, Positive Predictive Value (PPV) and Negative Predicitive Value (NPV) of [68Ga]GaDPI-4452 PET/CT imaging compared to histology, 42_Part D: Incidence and severity of TEAEs, serious TEAEs graded according to NCI-CTCAE v5.0 criteria, 43_Part E: Number and location of tumor lesions positive detected by [68Ga]Ga-DPI-4452 PET in comparison with the lesions identified by conventional imaging at baseline, 44_Part E: Incidence and severity of TEAEs, serious TEAEs graded according to National Cancer Institute Common Terminology Criteria for Adverse Events (NCI-CTCAE) v5.0 criteria

Source: https://euclinicaltrials.eu/ctis-public/view/2023-504254-35-00